EU clinical trial 2024-511730-12-00: Effects of blocking TSLP on airway inflammation and the epithelial immune-response to exacerbation triggers in patients with COPD A randomized double-blind, placebo-controlled trial of Tezepelumab
Protocol code: ESR-21-21168
Sponsor: Region Hovedstaden (Hospital/Clinic/Other health care facility). Phase: Therapeutic exploratory (Phase II). Countries: Denmark (ongoing, recruiting).
Therapeutic area(s): Diseases [C] - Respiratory Tract Diseases [C08]
Gender: Female, Male. Age: 18-64 years, 65+ years. Enrolment: 40.
Status: Ongoing, recruiting. Start date (EU): 2024-05-09. Decision date: 2024-05-08. Results received: No. Last updated: 2026-02-02.

Condition(s): Chronic obstructive pulmonary disease
Product: TEZEPELUMAB, PLACEBO

Primary endpoint: The change, expressed as ratio, in eosinophil cell counts per mm2 from baseline to week-20

Source: https://euclinicaltrials.eu/ctis-public/view/2024-511730-12-00